EU clinical trial 2023-509508-13-00: Dose escalation trial of BNT152+153 in patients with cancer
Protocol code: BNT152-01C
Sponsor: BioNTech SE (Pharmaceutical company). Phase: Human Pharmacology (Phase I)- First administration to humans. Countries: Czechia (ended).
Therapeutic area(s): Diseases [C] - Neoplasms [C04]
Gender: Female, Male. Age: 18-64 years, 65+ years. Enrolment: 2.
Status: Ended. Start date (EU): 2022-10-04. End date (EU): 2025-09-10. End date: 2025-09-11. Decision date: 2024-02-08. Results received: No. Last updated: 2025-08-19.

Condition(s): Various solid tumors that are metastatic or unresectable

Source: https://euclinicaltrials.eu/ctis-public/view/2023-509508-13-00